EU clinical trial 2024-515165-34-00: MiBlock - Botulinum toxin type A blockade of the sphenopalatine ganglion in treatment-refractory chronic migraine
Sponsor: St. Olavs Hospital HF (Hospital/Clinic/Other health care facility). Phase: Therapeutic confirmatory (Phase III). Countries: Norway (ended).
Therapeutic area(s): Diseases [C] - Nervous System Diseases [C10]
Gender: Female, Male. Age: 18-64 years, 65+ years. Enrolment: 170.
Status: Ended. Start date (EU): 2019-10-01. End date (EU): 2025-06-13. Decision date: 2024-07-12. Results received: Yes. Last updated: 2024-07-12.

Condition(s): Chronic migraine
Product: Natriumklorid B. Braun 9 mg/ml infusjonsvæske, oppløsning, BOTOX 100 Allergan-enheter Pulver til injeksjonsvæske, oppløsning

Primary endpoint: Difference in change from baseline in the mean monthly headache days at weeks 5 – 8 post intervention in the treatment versus the placebo group
Endpoint(s): Difference in occurrence of adverse events and serious adverse events in the treatment versus the placebo group, Difference in change from baseline in the mean monthly migraine days* in the treatment versus the placebo group, Difference in number of treatment responders (≥ 30% reduction in mean monthly headache days at weeks 5 – 8 post-intervention compared to baseline) in the treatment versus the placebo group., Difference in change from baseline in the mean monthly headache intensity in the treatment versus the placebo group., Difference in change from baseline in the mean monthly occurrence of cumulative hours per 28 days of moderate/severe pain in the treatment versus the placebo group., Difference in change from baseline in the mean monthly number of days with rescue medication in the treatment versus the placebo group., Migraine specific quality of life questionnaire

Source: https://euclinicaltrials.eu/ctis-public/view/2024-515165-34-00